EU clinical trial 2023-509286-20-00: Antibiotic THErapy iN vIral Airway iNfections (ATHENIAN): An open labelled randomized controlled pragmatic trial to evaluate the efficacy and safety of discontinuing antibiotic therapy in adult patients infected with respiratory viruses
Sponsor: Akershus University Hospital (Hospital/Clinic/Other health care facility). Phase: Therapeutic use (Phase IV). Countries: Norway (ongoing, recruiting).
Therapeutic area(s): Diseases [C] - Virus Diseases [C02]
Gender: Female, Male. Age: 18-64 years, 65+ years. Enrolment: 400.
Status: Ongoing, recruiting. Start date (EU): 2024-05-15. Decision date: 2024-05-15. Results received: No. Last updated: 2025-07-09.

Condition(s): Viral respiratory tract infection

Primary endpoint: Early clinical response assessed at 120 hours after randomization, defined as survival with symptom improvement without receipt of rescue antibacterial therapy
Endpoint(s): In-hospital mortality, Mortality at 30 days, Duration of hospital admission, Days of therapy with antibiotics, Rescue antibiotic therapy during hospital admission, New antibiotic therapy for presumed airway infection up to 30 days after discharge, Hospital readmissions up to 30 days after discharge

Source: https://euclinicaltrials.eu/ctis-public/view/2023-509286-20-00